EU clinical trial 2024-513410-35-00: Cerebral hemodynamic optimization by milrinone for the prevention of delayed cerebral ischemia in severe subarachnoid hemorrhage -OPTIMIL Study-
Protocol code: RC31/18/0472
Sponsor: Centre Hospitalier Universitaire De Toulouse (Hospital/Clinic/Other health care facility). Phase: Therapeutic confirmatory (Phase III). Countries: France (ongoing, recruiting).
Therapeutic area(s): Diseases [C] - Nervous System Diseases [C10]
Gender: Female, Male. Age: 18-64 years, 65+ years. Enrolment: 100.
Status: Ongoing, recruiting. Start date (EU): 2026-05-12. Decision date: 2024-09-16. Results received: No. Last updated: 2024-09-16.

Condition(s): aneurysmal subarachnoid hemorrhage
Product: MILRINONE, GLUCOSE 5% AGUETTANT, solution pour perfusion

Primary endpoint: The primary outcome is the volume of DCI lesions measured on a CT scan at 1 month
Endpoint(s): → Radiological parameters on CT at 1 month: -percentage of patients with DCI, → Evolution in intensive care: •Neurological complications: -number of episodes of PtiO2 below the ischemic threshold in intensive care: PtiO2 <20 mmHg (moderate hypoxia) and <15mmHg (severe hypoxia) for at least 15 minutes; - total duration of episodes of PtiO2 <20mmHg (moderate hypoxia) and <15mmHg (severe hypoxia) -number of recourse to an endovascular treatment -intracranial hypertension in intensive care: ICP> 20 mmHg for at least 15 minutes., Evolution in intensive care: • Number and type of non-neurological complications, → Evolution in intensive care: • Variation in general and cerebral hemodynamics (HR, MAP, ICP, CPP, transcranial Doppler velocity) with transthoracic cardiac ultrasound (TTE) cardiac output or pulse-wave contour study with transpulmonary thermodilution (PICCO) ®), → Evolution in intensive care: • Number of days in intensive care, → Evolution in intensive care: • Number of days with mechanical ventilation, → Prognosis: - neurological prognosis at 1 month, 3 months, 6 months and 1 year evaluated by the modified Rankin score (good prognosis: mRS 0, 1 and 2 / poor prognosis: mRS 3, 4 and 5) and the Glasgow Outcome Scale extended (good outcome: GOSE 5 to 8 / poor outcome: GOSE 1 to 4).- Sickness Impact Profile (SIP-65) quality-oflife scale at 3 months, 6 months and 1 year. - Mortality at 1 month, 3 months, 6 months and 1 year - number of days of hospitalization, → Number of adverse events, → Build up a biocollection for the evaluation of plasma brain biomarkers or other potential biomarkers

Source: https://euclinicaltrials.eu/ctis-public/view/2024-513410-35-00